EU clinical trial 2025-522860-34-00: A Phase 3, Open-Label, Randomized Study to Evaluate the Safety and Efficacy of BGB-16673 Compared to Pirtobrutinib in Patients With Relapsed/Refractory Chronic Lymphocytic Leukemia or Small Lymphocytic Lymphoma
Protocol code: BGB-16673-304
Sponsor: BeOne Medicines AG (Pharmaceutical company). Phase: Therapeutic confirmatory (Phase III). Countries: Sweden (ongoing, recruiting), Belgium (ongoing, recruiting), Spain (ongoing, recruiting), Germany (ongoing, recruiting), Austria (ongoing, recruiting), Netherlands (ongoing, recruiting), Italy (ongoing, recruiting), Romania (ongoing, recruiting), Poland (ongoing, recruiting), France (ongoing, recruiting).
Therapeutic area(s): Diseases [C] - Neoplasms [C04]
Gender: Female, Male. Age: 18-64 years, 65+ years. Enrolment: 196.
Status: Ongoing, recruiting. Start date (EU): 2025-12-16. Decision date: 2025-11-18. Results received: No. Last updated: 2026-06-15.
Decision dates by country: NL: 2025-11-24, BE: 2025-11-20, RO: 2025-11-24, SE: 2025-11-18, AT: 2025-11-23, IT: 2025-11-21, ES: 2025-11-21, PL: 2025-11-21, DE: 2025-11-19, FR: 2025-11-24

Condition(s): Small lymphocytic lymphoma (SLL), Chronic lymphocytic leukemia (CLL)
Product: Jaypirca 100 mg film-coated tablets, BGB-16673, BGB-16673

Primary endpoint: PFS, defined as time from the date of randomization to the date of first disease progression or death, whichever occurs first, as determined by IRC using modified 2018 International Workshop on Chronic Lymphocytic Leukemia (iwCLL) criteria for patients with chronic lymphocytic leukemia (CLL) and Lugano classification for patients with small lymphocytic lymphoma (SLL)
Endpoint(s): OS, defined as time from the date of randomization to the date of death due to any cause, PFS determined by investigator assessment, Overall response rate (partial response [PR] or better) determined by IRC and by investigator assessment, per modified 2018 iwCLL criteria for patients with CLL and Lugano classification for patients with SLL, Rate of PR with lymphocytosis or higher determined by IRC and by investigator assessment, Duration of response determined by IRC and by investigator assessment, Time to next anti-CLL/SLL treatment (TTNT), Incidence and severity of treatment-emergent adverse events (TEAEs), serious TEAEs, and laboratory abnormalities graded according to National Cancer Institute Common Terminology Criteria for Adverse Events (NCI-CTCAE) v5.0, Patient-reported symptoms of global health status (GHS), role functioning, and physical functioning, symptom burden and physical condition/fatigue measured by European Organization for Research and Treatment of Cancer (EORTC) quality of life questionnaire IL409 (an itemized version of EORTC quality of life questionnaire core 30 [QLQ-C30] and its CLL module CLL17)

Source: https://euclinicaltrials.eu/ctis-public/view/2025-522860-34-00